EU clinical trial 2024-514196-17-00: A no-profit, open-label, phase II pilot study on the efficacy and safety of Alpelisib in patients with Dent 2 disease (ALPEDENT study)
Protocol code: ALPEDENT_OPBG_2024
Sponsor: Ospedale Pediatrico Bambino Gesu (Hospital/Clinic/Other health care facility). Phase: Therapeutic exploratory (Phase II). Countries: Italy (ongoing, recruiting).
Therapeutic area(s): Diseases [C] - Male Urogenital Diseases [C12]
Gender: Male. Age: 18-64 years. Enrolment: 4.
Status: Ongoing, recruiting. Start date (EU): 2025-03-14. Decision date: 2025-01-17. Results received: No. Last updated: 2025-01-17.

Condition(s): Dent 2 disease
Product: Piqray 150 mg film-coated tablets, Piqray 50 mg and 200 mg film-coated tablets, RENOCIS 1 mg kit for radiopharmaceutical preparation

Primary endpoint: Improvement in the renal uptake of 99mTc-DMSA after 4 weeks of treatment (a p-value of ≤ 0.05 will be used to determine statistical significance).
Endpoint(s): Improvement of low-molecular weight proteinuria as assessed by changes urinary excretion of retinol-binding protein and beta-2 microglobulin after 4 weeks of treatment (a p-value of ≤ 0.05 will be used to determine statistical significance). − Improvement of the Fanconi syndrome as assessed by including 24-hour urine volume, urinary excretion of sodium, glucose, phosphate, amino acids, and changes in serum bicarbonate after 4 weeks of treatment (a p-value of ≤ 0.05 to determine statis sign)

Source: https://euclinicaltrials.eu/ctis-public/view/2024-514196-17-00